EU clinical trial 2024-516907-18-00: A Study to Learn About How Different Formulations of the Medicine Called Mevrometostat are Taken up Into the Blood in Healthy Adult Participants
Protocol code: C2321006
Sponsor: Pfizer Inc. (Pharmaceutical company). Phase: Human Pharmacology (Phase I)- Other. Countries: Belgium (ended).
Therapeutic area(s): Diseases [C] - Neoplasms [C04]
Gender: Female, Male. Age: 18-64 years, 65+ years. Enrolment: 16.
Status: Ended. Start date (EU): 2024-11-20. End date (EU): 2025-02-25. Decision date: 2024-11-19. Results received: No. Last updated: 2024-11-19.

Condition(s): Small cell lung cancer, Castration-resistant prostate cancer, Follicular lymphoma

Source: https://euclinicaltrials.eu/ctis-public/view/2024-516907-18-00